EU clinical trial 2022-501406-36-00: Study of safety, tolerability and efficacy of DFV890 in adult participants with myeloid diseases
Protocol code: CDFV890G12101
Sponsor: Novartis Pharma AG (Pharmaceutical company). Phase: Human Pharmacology (Phase I)- Other. Countries: France (ended), Italy (ended), Germany (ongoing, recruitment ended), Spain (ongoing, recruitment ended).
Therapeutic area(s): Diseases [C] - Neoplasms [C04]
Gender: Female, Male. Age: 18-64 years, 65+ years. Enrolment: 39.
Start date (EU): 2023-12-14. Decision date: 2023-03-29. Results received: No. Last updated: 2026-06-26.
Decision dates by country: IT: 2023-03-29, ES: 2023-03-29, FR: 2023-03-29, DE: 2023-03-30

Condition(s): Myeloid disease

Source: https://euclinicaltrials.eu/ctis-public/view/2022-501406-36-00